EU clinical trial 2023-505359-37-00: A Phase 2, Randomized, Observer-Blind, Placebo-Controlled, Dose-Escalation Study to Evaluate the Reactogenicity, Safety, and Immunogenicity of mRNA-1345, an mRNA Vaccine Targeting Respiratory Syncytial Virus, in Pregnant Women, and Safety, and Immunogenicity in Infants Born to Vaccinated Mothers.
Protocol code: mRNA-1345-P201
Sponsor: Moderna Inc. (Pharmaceutical company). Phase: Therapeutic exploratory (Phase II). Countries: Denmark (ended).
Therapeutic area(s): Diseases [C] - Respiratory Tract Diseases [C08]
Gender: Female. Age: 0-17 years, 18-64 years. Enrolment: 25.
Status: Ended. Start date (EU): 2024-09-03. End date (EU): 2025-04-30. End date: 2026-05-25. Decision date: 2024-03-25. Results received: No. Last updated: 2025-02-20.

Condition(s): Respiratory syncytial virus
Product: SODIUM CHLORIDE SOLUTION 0.9%, mRNA-1345

Primary endpoint: Maternal Participants: • Solicited local and systemic adverse reactions through 7 days after study intervention. • Unsolicited adverse events through 28 days after study intervention. • Medically attended adverse events from Day 1 to Month 6 (6 months postdelivery)., Adverse events of special interest from Day 1 to Month 12 (12 months postdelivery)/EoS Visit. • Serious adverse events from Day 1 to Month 12 (12 months postdelivery)/EoS visit. • Adverse events leading to discontinuation from Day 1 to Month 12 (12 months postdelivery)/EoS Visit. • Pregnancy outcomes (mode and nature of delivery)., Infant Participants • Medically attended adverse events from Day 1 (birth) to Month 12/EoS Visit. • Adverse events of special interest from Day 1 (birth) to Month 12/EoS Visit. • Serious adverse events from Day 1 (birth) to Month 12/EoS Visit. • Birth outcomes (gestational age and anthropometric measurements)
Endpoint(s): Maternal Participants: • GMT of serum RSV-A and RSV-B neutralizing antibody at Day 1, Day 29, delivery, and Month 6 (6 months postdelivery). • GMC of serum RSV-F binding antibody at Day 1, Day 29, delivery, and Month 6 (6 months postdelivery)., GMFR of Postbaseline/Baseline neutralizing antibody titers and binding antibody concentrations at Day 29, delivery, and Month 6 (6 months postdelivery). • Proportion of participants with ≥4-fold increases in neutralizing antibody titers and binding antibody concentrations from Baseline., Infant Participants: • GMT of serum RSV-A and RSV-B neutralizing antibody at Day 1 (birth)a, and Months 2, 6, and 12. • GMC of serum RSV-F binding antibody at Day 1 (birth)a, and Months 2, 6, and 12., Maternal and Infant Participants: • Additional markers of immune response to vaccination, including transcriptomic analysis., RSV neutralizing and binding antibodies in breast milk. • Frequency, magnitude, and/or phenotype of vaccine-specific B-cell and T-cell responses measured by flow cytometry or other methods, Infant Participants: • RSV-RTI. • RSV-LRTI. • Severe RSV-LRTI. • RSV very severe LRTI. • RSV hospitalization.

Source: https://euclinicaltrials.eu/ctis-public/view/2023-505359-37-00